EU clinical trial 2022-502193-16-00: A Randomized, Multi-Center, Parallel, Double-Blinded, Placebo-Controlled Clinical Trial to Evaluate Efficacy, Safety, and Pharmacokinetics of XEMBIFY® plus Standard Medical Treatment Compared to Placebo plus Standard Medical Treatment to Prevent Infections in Patients with Hypogammaglobulinemia and Recurrent or Severe Infections Associated with B-cell Chronic Lymphocytic Leukemia, Multiple Myeloma, and Non-Hodgkin Lymphoma
Protocol code: GC2202
Sponsor: Grifols Therapeutics LLC (Pharmaceutical company). Phase: Therapeutic confirmatory (Phase III). Countries: Romania (ongoing, recruiting), Poland (ongoing, recruiting), Hungary (ongoing, recruiting), Bulgaria (ongoing, recruiting), Croatia (ongoing, recruiting).
Therapeutic area(s): Diseases [C] - Neoplasms [C04]
Gender: Female, Male. Age: 18-64 years, 65+ years. Enrolment: 94.
Status: Ongoing, recruiting. Start date (EU): 2023-11-14. Decision date: 2023-07-28. Results received: No. Last updated: 2026-06-15.
Decision dates by country: BG: 2023-08-14, PL: 2023-08-03, HR: 2025-05-06, HU: 2023-08-10, RO: 2023-07-28

Condition(s): Chronic lymphocytic leukemia, Multiple Myeloma and Non-Hodgkin Lymphoma
Product: SODIUM CHLORIDE, Xembify 200 mg/ml solución inyectable subcutánea

Primary endpoint: Annual rate of major infections* (bacterial; infections per year). *Major bacterial infections for the primary endpoint are defined in the appendix “Diagnostic Criteria for Serious Infection Types” from the FDA IVIG PID guidance 2008, which includes bacteremia/sepsis, bacterial meningitis, osteomyelitis/septic arthritis, bacterial pneumonia, and visceral abscess
Endpoint(s): Time to first onset of major bacterial infection, Proportion of subjects who experience major bacterial infections, Rate of all bacterial infections (serious/non-serious) as determined by the investigator, Time to first onset of non-major bacterial infections, Proportion of subjects who experience bacterial infections, Number of days on antibiotics (including oral, parenteral, oral plus parenteral, prophylactic, and therapeutic) in all subjects, Number of hospitalizations and duration due to any infections, Number of hospitalizations and duration due to major bacterial infections, The rate of all infections of any kind (serious/nonserious) as determined by the Investigator, Validated infections documented by positive radiograph, fever (>38°C [>100.4°F] oral or >39°C [>102.2°F] rectal), culture, or diagnostic testing for microorganisms, e.g., bacterial, viral, fungal, or protozoal pathogens (e.g., rapid streptococcal antigen detection test), Time to first onset of any infection

Source: https://euclinicaltrials.eu/ctis-public/view/2022-502193-16-00